EU clinical trial 2023-504592-24-00: Early intervention and recovery of sexual function in men and women after treatment of rectal cancer–a randomized controlled study with tadalafil compared to standard care
Protocol code: 30July2021Version6.0
Sponsor: Karolinska Institutet (Educational Institution). Phase: Therapeutic exploratory (Phase II). Countries: Sweden (authorised, recruitment pending).
Therapeutic area(s): Not possible to specify
Gender: Female, Male. Age: 18-64 years, 65+ years. Enrolment: 80.
Status: Authorised, recruitment pending. Decision date: 2024-09-27. Results received: No. Last updated: 2024-09-27.

Condition(s): sexual/ erectile function in women and men after treatment for rectal cancer
Product: CIALIS 5 mg film-coated tablets

Primary endpoint: Women: Change between baseline and 24 months in sexual function assessed with the total score of the Female Sexual Function Index (FSFI- 6)., Men: Change between baseline and 24 months in erectile function assessed with the total score of the short version of the International Index of Erectile Function (IIEF-5).
Endpoint(s): Change from baseline to 24 months on the proportion of women with severe sexual dysfunction defined as a FSFI-6 score below 20 at baseline and the proportion of men with severe erectile dysfunction defined as IIEF-5 score of 5-7 at baseline., Change from baseline to 24 months on the proportion of sexually active women defined as score 0 on question 2, 3 or 4 in the FSFI-6 questionnaire at baseline., Change from baseline to 24 months on the proportion of women who attempt intercourse defined as score 0 on question 6 in the FSFI-6 questionnaire at baseline., Change from baseline to 24 months on the proportion of sexually active men defined as score "X" (no sexual activity) on question 2, 3, 4 or 5 in the IIEF-5 questionnaire at baseline., Proportion of patients with use of PDE5-inhibitors at least once per month between 6-24 months after surgery for rectal cancer (PDE5- inhibitors users)., Fibrosis:Women: Change from baseline to 24 months in size of pain-free introducible vaginal dilator (4 XML File Identifier: pCoXtm4xKBCBEk2OP0cw1CYwmjU= Page 12/23 categories)., Fibrosis: Men: Change from baseline to 24 months in penile length in flaccid state, Change from baseline to 24 months in total and free testosterone, LH, albumin and sex hormone binding globuline (SHBG)., Change from baseline to 24 months in Low Anterior Resection Syndrome Score (LARS) or the Colostomy Impact Score (CI) respectively., Change from baseline to 24 months in urinary function (questionnaire) – descriptive statistics., Adverse events from baseline to 6 months after surgery for rectal cancer.

Source: https://euclinicaltrials.eu/ctis-public/view/2023-504592-24-00